EU clinical trial 2025-524093-41-00: INCREDIBLE: INCREmental DIalysis and diet for a Better Life Experience; Clinical relevance of an “add-on” Ketosteril supplementation on incremental haemodialysis period in incident haemodialysis patients. An exploratory randomized controlled trial
Sponsor: Centre Hospitalier Le Mans (Hospital/Clinic/Other health care facility). Phase: Therapeutic exploratory (Phase II). Countries: France (authorised, recruitment pending).
Therapeutic area(s): Diseases [C] - Nutritional and Metabolic Diseases [C18]
Gender: Female, Male. Age: 18-64 years, 65+ years. Enrolment: 70.
Status: Authorised, recruitment pending. Decision date: 2026-05-18. Results received: No. Last updated: 2026-05-18.

Condition(s): Incremental Haemodialysis
Product: Ketosteril, comprimé enrobé

Primary endpoint: Duration in months of the incremental Haemodialysis period (defined as less than 3 times per week but excluding the cases in which dialysis frequency is reduced in the context of palliative and end-of life care)
Endpoint(s): Mortality (patients who discontinue dialysis in the context of an “end of life care project” are considered as deceased at the start of the program of palliative care), Hospitalization rates (all causes), excluding the hospitalization at dialysis start and hospitalization for end-of-life care, Combined outcome mortality and hospitalization, Quality of life (WHO QoL), and perceived diet quality (MDRD diet quality questionnaire); Council on Nutrition Appetite Questionnaire (CNAQ) are performed at start of treatment and every 3 months, Nutritional status, according to the main usual biochemical and clinical markers (albumin, hemoglobin, CRP, pre-albumin levels; need for ESAs; weigh, BMI; body composition (bioimpedance); handgrip strength measurement), SGA, MIS, in keeping with the recommendations of the KDOQI guidelines 2020, Costs related to incremental Haemodialysis and Ketosteril, with respect to costs of standard Haemodialysis, Sustainability (savings in terms of water, energy, wastes, related to the reduction of the dialysis sessions)

Source: https://euclinicaltrials.eu/ctis-public/view/2025-524093-41-00